EU clinical trial 2024-514870-29-00: A phase I/II study evaluating safety and efficacy of autologous hematopoietic stem and progenitor cells genetically modified with IDUA lentiviral vector encoding for the human α-L-iduronidase gene for the treatment of patients affected by Mucopolysaccharidosis Type I, Hurler variant
Protocol code: TigetT10_MPSIH
Sponsor: Orchard Therapeutics (Europe) Limited (Pharmaceutical company). Phase: Phase I and Phase II (Integrated)- First administration to humans. Countries: Italy (ongoing, recruitment ended).
Therapeutic area(s): Phenomena and Processes [G] - Genetic Phenomena [G05]
Gender: Female, Male. Age: 0-17 years. Enrolment: 8.
Status: Ongoing, recruitment ended. Start date (EU): 2018-05-14. Decision date: 2024-07-23. Results received: No. Last updated: 2026-07-01.

Condition(s): Mucopolysaccharidosis type I Hurler
Product: OTL-203, RITUXIMAB, FLUDARABINE, BUSULFAN, LENOGRASTIM, PLERIXAFOR

Primary endpoint: Overall survival from Advanced Therapy Investigational Medicinal Product (ATIMP) injection, Achievement of hematological engraftment less than or equal to day +45 from Advanced Therapy Investigational Medicinal Product (ATIMP) injection. Hematologic engraftment is defined as the first of 3 consecutive days with neutrophil count > 500/mm3 and platelets > 20,000/mm3 (in the absence of platelet transfusion for seven consecutive days)., Safety of the administration of autologous HSPC transduced with LVV-IDUA. This will be measured as: a) short-term tolerability (0-24 hours from ATIMP injection); b) absence of Replication Competent Lentivirus (RCL); c) absence of malignancy or abnormal clonal proliferation due to insertional mutagenesis., Overall safety and tolerability measured by Adverse Event (AE) recording., IDUA activity in blood (dried blood spot, DBS) (up to supraphysiologic levels) at 1-year posttreatment
Endpoint(s): Achievement of supraphysiologic IDUA activity in blood (DBS), IDUA activity in plasma, Engraftment of transduced cells >= 0.30 vector copy number (VCN)/genome, Normalization of urinary GAGs, Normalization of spleen and liver (for age), Growth velocity, Anti-IDUA antibody immune response before and after infusion of IDUA LVV-transduced cells

Source: https://euclinicaltrials.eu/ctis-public/view/2024-514870-29-00